EU clinical trial 2024-517011-74-01: Single center, decentralized, parallel group, open, non-randomized, long-term safety follow-up, and exploratory study of long-term effects on inflammatory, immunological, and aging related biomarkers in study participants treated with MSCs.
Protocol code: 2024-001-SWE
Sponsor: Cellcolabs AB (Pharmaceutical company). Phase: Phase III and phase IV (Integrated). Countries: Sweden (ended).
Therapeutic area(s): Not possible to specify
Gender: Female, Male. Age: 18-64 years, 65+ years. Enrolment: 200.
Status: Ended. End date (EU): 2026-03-24. Decision date: 2025-01-08. Results received: No. Last updated: 2025-08-13.

Condition(s): Not possible to specify
Product: StromaForte MSC solution for infusion

Primary endpoint: Adverse Event and Serious Adverse Event rates, including clinically significant laboratory abnormalities.
Endpoint(s): Change from baseline and after MSC treatment in EQ-5D-5L dimensions, Change from baseline in laboratory parameters.

Source: https://euclinicaltrials.eu/ctis-public/view/2024-517011-74-01